EU clinical trial 2024-514585-39-00: A Randomized, Double-Blind, Placebo-Controlled Trial of Adjunctive Troriluzole in Obsessive Compulsive Disorder
Protocol code: BHV4157-303
Sponsor: Biohaven Pharmaceuticals Inc. (Pharmaceutical company). Phase: Therapeutic confirmatory (Phase III). Countries: Spain (ended), Italy (ended).
Therapeutic area(s): Psychiatry and Psychology [F] - Behavioral Disciplines and Activities [F04]
Gender: Female, Male. Age: 18-64 years, 65+ years. Enrolment: 100.
Status: Ended. Start date (EU): 2021-07-12. End date (EU): 2025-01-11. End date: 2025-04-29. Decision date: 2024-07-30. Results received: Yes. Last updated: 2025-01-29.
Decision dates by country: IT: 2024-07-30, ES: 2024-07-30

Condition(s): Obsessive Compulsive Disorder
Product: Troriluzole, Placebo for BHV-4157 capsules, 100mg, 140mg, Troriluzole

Primary endpoint: Improvement in obsessive-compulsive symptomatology is assessed using the Y-BOCS change from baseline in the total score.
Endpoint(s): The change from baseline on the SDS total score and the CGI Severity score.

Source: https://euclinicaltrials.eu/ctis-public/view/2024-514585-39-00